EU clinical trial 2024-516172-15-00: COPD-CARhE - Chronic Airway Disease, Mucus Rheology and Exacerbations: a Randomized Controlled Trial of COPD Patients
Sponsor: Centre Hospitalier Universitaire De Montpellier (Hospital/Clinic/Other health care facility). Phase: Therapeutic exploratory (Phase II). Countries: France (ongoing, recruiting).
Therapeutic area(s): Diseases [C] - Respiratory Tract Diseases [C08]
Gender: Female, Male. Age: 18-64 years, 65+ years. Enrolment: 72.
Status: Ongoing, recruiting. Start date (EU): 2023-02-03. Decision date: 2024-08-13. Results received: No. Last updated: 2025-04-04.

Condition(s): Chronic Obstructive Pulmonary Disease
Product: AZITHROMYCIN DIHYDRATE

Primary endpoint: The number of exacerbations over the 12 months of follow-up
Endpoint(s): The number of mild exacerbations throughout follow-up. A mild exacerbation does not require new additional medicine, The number of moderate exacerbations throughout follow-up. Moderate exacerbations require antibiotics or oral corticosteroids (but not hospitalization), The number of severe exacerbations throughout follow-up. Severe exacerbations require hospitalization, Comparison on the evolution of symptoms assessed by the COPD Assessment Test (CAT) questionnaire score at 3 months, 6 months, 9 months and 12 months, Comparison on the evolution of symptoms assessed by the score of the Cough and sputum assessment questionnaire (CASA-Q) questionnaire score at 3 months, 6 months, 9 months and 12 months, Comparison on the evolution of symptoms assessed by the score of the Visual analogue scale (VAS) score for dyspnea, coughing and sputum production at 3 months, 6 months, 9 months and 12 months, Comparison on sputum rheology (modulus of elasticity of mucus, parameter G' ) measured using the Rheomuco device at 3 months, 6 months, 9 months and 12 months, Comparison on sputum rheology (viscous module, parameter G'') measured using the Rheomuco device at 3 months, 6 months, 9 months and 12 months, Comparison on sputum rheology (ratio G ''/G ') measured using the Rheomuco device at 3 months, 6 months, 9 months and 12 months, Comparison on sputum rheology (critical constraint, parameter tau-C) measured using the Rheomuco device at 3 months, 6 months, 9 months and 12 months, Comparison on pulmonary function (forced expiratory volume in 1 s, FEV1) measured by Spirometry at 3 months, 6 months, 9 months and 12 months, Comparison on pulmonary function (forced vital capacity, FVC) measured by Spirometry at 3 months, 6 months, 9 months and 12 months, Comparison on pulmonary function (FEV1/FVC ratio) measured by Spirometry at 3 months, 6 months, 9 months and 12 months, Comparison on pulmonary function (residual volume, RV) measured by Plethysmography at baseline and 12 months, Comparison on pulmonary function (functional residual capacity, FRC) measured by Plethysmography at baseline and 12 months, Comparison on pulmonary function (total lung capacity, TLC) measured by Plethysmography at baseline and 12 months, Comparison on pulmonary function (ratio RV/TLC) measured by Plethysmography at baseline and 12 months, Comparison on drug consumption throughout follow-up, Number of adverse events throughout follow-up, Comparison on number of days with exacerbations and associated symptoms / treatments throughout follow-up, Comparison on number of days of hospitalizations and associated symptoms / treatments throughout follow-up, Clinical improvement comparison scored via a point system from 0 to 3 at the end of the study (1 point: no more than one exacerbation without hospitalization during the 52 weeks of follow-up; 1 point: gain > 100mL in pre-bronchodilator FEV1 at the 52nd week compared to the baseline state; 1 point: variation of the CAT score during the 52 weeks of observation > 2), Comparison on the evolution of quality of life by the score of the EQ-5D-5L questionnaire score at 3 months, 6 months, 9 months and 12 months, Comparison on the evolution of quality of life by the score of the St-George’s Respiratory questionnaire score at 3 months, 6 months, 9 months and 12 months, Change in complete blood counts, including neutrophils, eosinophils between baseline and the end of the study, Change in level of Serum Club cell secretory protein between baseline and the end of the study, Comparison on number of exacerbations between the experimental and comparator arms without prescription of azithromycin, Comparison on number of exacerbations between the experimental and comparator arms with prescription of azithromycin, Assessment of Azithromycin prescription according to CASA-Q in the experimental arm

Source: https://euclinicaltrials.eu/ctis-public/view/2024-516172-15-00